EU clinical trial 2025-521611-39-00: A Phase 2a Trial to Investigate Safety, Tolerability and Exploratory Clinical Efficacy of AGP100 in Patients with Catecholaminergic Polymorphic Ventricular Tachycardia
Protocol code: AGP100-C01
Sponsor: Agiana Pharmaceuticals AS (Pharmaceutical company). Phase: Therapeutic exploratory (Phase II). Countries: Norway (ongoing, recruiting).
Therapeutic area(s): Diseases [C] - Cardiovascular Diseases [C14]
Gender: Female, Male. Age: 18-64 years, 65+ years. Enrolment: 10.
Status: Ongoing, recruiting. Start date (EU): 2025-12-18. Decision date: 2025-10-16. Results received: No. Last updated: 2025-12-04.

Condition(s): Catecholaminergic Polymorphic Ventricular Tachycardia
Product: DNS-6288, DNS-6288

Primary endpoint: Safety: Incidence of AEs from receipt of the first dose of IMP and changes in standard safety assessments (which include physical examinations, vital signs, body weight, 12-lead ECG, and safety laboratory assessments), Tolerability (‘Tolerable Yes or No’): If any of following changes in IMP dosing is deemed necessary, the participant will be classified as ‘No’. • Dose adjustments prescribed by the Investigator • Dose interruptions prescribed by the Investigator • Discontinuation of treatment
Endpoint(s): Change from Baseline in the amount and complexity of exercise-induced ventricular ectopic beats as assessed using the ventricular arrythmia (VA) score at Day 1, Day 14, Day 27, Day 39, and Day 68., Change from Baseline in urine and plasma cGMP and cAMP levels at Day 1 (post-dose), Day 14, Day 27, Day 39, and Day 68.

Source: https://euclinicaltrials.eu/ctis-public/view/2025-521611-39-00